EU clinical trial 2026-526708-56-00: A Phase 1, Randomized, Placebo-Controlled, Multiple-Dose, Dose-Ranging Trial to Evaluate the Safety, Tolerability, Pharmacokinetics, and Pharmacodynamics of Subcutaneous CTX611 in Healthy Adult Participants
Protocol code: CRSP-611-101
Sponsor: CRISPR Therapeutics AG (Pharmaceutical company). Phase: Human Pharmacology (Phase I)- Other. Countries: Hungary (ongoing, recruiting).
Therapeutic area(s): Diseases [C] - Cardiovascular Diseases [C14]
Gender: Female, Male. Age: 18-64 years. Enrolment: 48.
Status: Ongoing, recruiting. Start date (EU): 2026-07-17. Decision date: 2026-07-10. Results received: No. Last updated: 2026-07-10.

Condition(s): Thromboembolic disorders

Source: https://euclinicaltrials.eu/ctis-public/view/2026-526708-56-00